EU clinical trial 2025-520638-53-00: Evaluation of the Analgesic Effect of Intramyometrial Botulinum Toxin Injection via Hysteroscopy in pelvic pain suggestive of dysmenorrhea: A Prospective, Multicenter, Double-Blind, Randomized Placebo-Controlled Study. HYSTEROXINE Study
Protocol code: RC24_0428
Sponsor: Centre Hospitalier Universitaire De Nantes (Hospital/Clinic/Other health care facility). Phase: Therapeutic confirmatory (Phase III). Countries: France (ongoing, recruiting).
Therapeutic area(s): Diseases [C] - Female Urogenital Diseases and Pregnancy Complications [C13]
Gender: Female. Age: 18-64 years. Enrolment: 222.
Status: Ongoing, recruiting. Start date (EU): 2026-02-09. Decision date: 2025-07-16. Results received: No. Last updated: 2026-07-08.

Condition(s): Severe primary dysmenorrhea
Product: XEOMIN 200 unités, poudre pour solution injectable, Placebo to NT201

Primary endpoint: The primary endpoint is the response (favorable versus unfavorable) to the Patient Global Impression of Improvement (PGI-I) questionnaire at 3 months after the intra-myometrial injection. The response is considered favorable when the PGI-I score is 1 or 2.
Endpoint(s): Average and maximum intensity of dysmenorrhea evaluated using a Visual Analog Scale and duration (in days) during the last cycle before injection, then at 3 and 6 months., Average and maximum intensity of pelvic pain outside of menstruation, evaluated using a Visual Analog Scale before injection, then at 1, 3, and 6 months, and duration (in days)., Average and maximum intensity of pain during the last sexual intercourse, evaluated using a Visual Analog Scale before injection, then at 1, 3, and 6 months., Sexual function scale, Female Sexual Function Index (FSFI), evaluated before injection, then at 1, 3, and 6 months., Central sensitization pain score, Convergences PP, evaluated before injection, then at 3 months, Higham score for evaluating menstrual blood loss, assessed before injection, then at 3 and 6 months. Duration (in days) of menstruation during the last cycle evaluated before injection, then at 3 and 6 months., Global quality of life score SF-36 and specific quality of life score EHP-5, evaluated before injection, then at 1, 3, and 6 months., Number of days of school or work absenteeism during the last month, assessed before injection, then at 1, 3, and 6 months, Anxiety score STAI-Y evaluated before injection and at 3 months. Depression score, Beck Depression Inventory (BDI-II), evaluated before injection and at 3 months., Percentage of overall improvement (0-100%) evaluated at 1, 3, and 6 months. Patient Global Impression of Improvement (PGI-I) evaluated at 1 and 6 months. Patient’s willingness to undergo the intervention again (Yes/No) at 6 months and collection of justification., Pain intensity experienced during the procedure and at 5 minutes, evaluated using a Visual Analog Scale, Adverse effects related to the injections collected in the immediate postoperative period, then at 1, 3, and 6 months, Occurrence of emergency consultations in the postoperative period, evaluated at 1 month, For the exploratory analysis of the MEOPA subgroup: primary endpoint, pain during the procedure, willingness to undergo the intervention again, adverse effects, and postoperative consultations, For the exploratory analysis of the hormonal treatment subgroup: all primary and secondary endpoints, For the exploratory analysis of the amenorrheic and non-amenorrheic patients subgroup: all primary and secondary endpoints

Source: https://euclinicaltrials.eu/ctis-public/view/2025-520638-53-00